EU clinical trial 2023-510076-31-00: A single center, single arm, Phase 2, pilot study to investigate the efficacy of an angiotensin-converting enzyme inhibitor (ACE-inhibitor) in male and female participants aged 18-70 years of age with painful venous malformations.
Sponsor: Oslo University Hospital HF (Hospital/Clinic/Other health care facility). Phase: Therapeutic exploratory (Phase II). Countries: Norway (ongoing, recruiting).
Therapeutic area(s): Diseases [C] - Congenital, Hereditary, and Neonatal Diseases and Abnormalities [C16]
Gender: Female, Male. Age: 18-64 years, 65+ years. Enrolment: 10.
Status: Ongoing, recruiting. Start date (EU): 2025-01-30. Decision date: 2024-06-14. Results received: No. Last updated: 2024-12-17.

Condition(s): Venous malformation
Product: Enalapril Viatris 5 mg comprimidos EFG

Primary endpoint: Change in NRS score 12 months after treatment start with enalapril compared to baseline.
Endpoint(s): Volume change on MRI 12 months after treatment start with enalapril compared to baseline., Change in Quality of life 12 months after treatment start with enalapril compared to baseline., Register adverse events > or equal to grade 2 and side effects continues during the study

Source: https://euclinicaltrials.eu/ctis-public/view/2023-510076-31-00